EU clinical trial 2025-520780-40-00: A Phase 2a, Randomized, Double-blind, Placebo-controlled, Parallel-Group, Multicenter Study to Evaluate the Efficacy, Safety, Tolerability, Pharmacokinetics, Pharmacodynamics, and Immunogenicity of ALXN1920 in Adult Participants with PMN (Primary Membranous Nephropathy) who are at a High Risk for Disease Progression (AUTUMN)
Protocol code: ALXN1920-PMN-201
Sponsor: Alexion Pharmaceuticals Inc. (Pharmaceutical company). Phase: Therapeutic exploratory (Phase II). Countries: Spain (ongoing, recruiting), France (authorised, recruiting), Italy (ongoing, recruiting).
Therapeutic area(s): Diseases [C] - Immune System Diseases [C20]
Gender: Female, Male. Age: 18-64 years, 65+ years. Enrolment: 9.
Start date (EU): 2025-11-26. Decision date: 2025-11-20. Results received: No. Last updated: 2026-06-22.
Decision dates by country: FR: 2025-11-24, IT: 2025-11-21, ES: 2025-11-20

Condition(s): Primary Mebranous Nephropathy (PMN)
Product: Alxn1920 placebo product, ALXN1920

Primary endpoint: Change from Baseline in proteinuria based on 24-hour UPCR
Endpoint(s): Change from Baseline in proteinuria based on 24-hour UPCR, Change from Baseline in proteinuria based on spot UPCR, Change from Baseline in serum albumin, Change from Baseline in anti-PLA2R antibody level, Change from Baseline in Peripheral CD19+ B cell count, Percentage of participants who achieve a CR, Percentage of participants who achieve a CR or PR, Change from Baseline for urine biomarkers, Incidence of TEAEs and TESAEs over time, Change from Baseline in safety parameters, vital signs, ECGs over time, Serum and urine ALXN1920 concentrations over time, Absolute values, change from Baseline, and percent change from Baseline in serum CAP activity and serum fH levels over time, ADA incidence, category of immune response, and titer through the duration of the study, Change from Baseline for urine biomarkers

Source: https://euclinicaltrials.eu/ctis-public/view/2025-520780-40-00